EU clinical trial 2023-507106-13-00: Evaluating PD-1/PD-L1 in rectal cancer by quantitative fluorescence molecular endoscopy.
Protocol code: 17651
Sponsor: Universitair Medisch Centrum Groningen (Hospital/Clinic/Other health care facility). Phase: Human Pharmacology (Phase I)- First administration to humans. Countries: Netherlands (ongoing, recruiting).
Therapeutic area(s): Diseases [C] - Neoplasms [C04]; Diseases [C] - Digestive System Diseases [C06]
Gender: Female, Male. Age: 18-64 years, 65+ years. Enrolment: 23.
Status: Ongoing, recruiting. Start date (EU): 2026-01-12. Decision date: 2024-03-18. Results received: No. Last updated: 2025-12-08.

Condition(s): Locally advanced rectal cancer

Source: https://euclinicaltrials.eu/ctis-public/view/2023-507106-13-00